EU clinical trial 2024-515989-14-00: A phase II study of Sonidegib in Nevoid Basal Cell Carcinoma Syndrome (Gorlin) syndrome and sporadic BCC patients in EADO stage IIb. SIBLINGS TRIAL
Protocol code: SIBLINGS
Sponsor: Gruppo Oncologico Del Nord Ovest (Patient organisation/association). Phase: Therapeutic exploratory (Phase II). Countries: Italy (ongoing, recruiting).
Therapeutic area(s): Diseases [C] - Neoplasms [C04]
Gender: Female, Male. Age: 18-64 years, 65+ years. Enrolment: 15.
Status: Ongoing, recruiting. Start date (EU): 2025-04-17. Decision date: 2025-02-21. Results received: No. Last updated: 2025-12-18.

Condition(s): Nevoid Basal Cell Carcinoma Syndrome
Product: Odomzo 200 mg hard capsules

Primary endpoint: A discontinuation rate <54% due to AEs at 40 weeks from study entry in a NBCCS - population/sporadic BCC patients in EADO stage IIb treated for 16 weeks with daily sonidegib followed by a pulsed dosing for the subsequent 24 weeks.
Endpoint(s): The ORR according to RECIST criteria., The PFS at 40 weeks from study entry., The DOR of a pulsed sonidegib regimen., The rate of any grade drug related (DR) AEs and G3/4 DR AEs of a pulsed sonidegib regimen in a NBCCS - population / sporadic BCC patients in EADO stage IIb after 16 weeks with daily sonidegib., The EORTC QLQ C30 score at baseline, after 16 weeks of continuous daily sonidegib therapy, and after 24 weeks of pulsed sonidegib regimen.

Source: https://euclinicaltrials.eu/ctis-public/view/2024-515989-14-00